EU clinical trial 2024-513499-16-00: NeuroPET GBG 001 - Mapping pathogenic processes associated with the development of neurodegenerative disorders using novel neuroimaging modalities
Sponsor: Vaestra Goetalandsregionen (Hospital/Clinic/Other health care facility). Phase: Therapeutic exploratory (Phase II). Countries: Sweden (ongoing, recruiting).
Therapeutic area(s): Diseases [C] - Nervous System Diseases [C10]
Gender: Female, Male. Age: 18-64 years, 65+ years. Enrolment: 300.
Status: Ongoing, recruiting. Start date (EU): 2024-10-08. Decision date: 2024-10-08. Results received: No. Last updated: 2024-10-08.

Condition(s): Neurodegenerative diseases
Product: RO948 (18F), Sahlgrenska

Primary endpoint: Standardized uptake value ratios of [18]F-R0948 in selected cortical brain regions (normalized to a reference region).
Endpoint(s): CSF measures of sAPPalpha, sAPPbeta, Aβ38, Aβ40, Aβ42, p-tau181, ptau231, total (t-) tau, neurofilament light (NFL), H-FABP, ViliP-1, SNAP-25, dendritic protein neurogranin, CSF/serum albumin ratio, MBP, cytokines, YKL-40, SV2A, and chitotriosidase, Structural and functional measures derived from MRI (cortical volumes and thickness, BOL T signal in selected brain regions, white matter and vascular changes, changes in diffusion), Cognitive performance as assessed by neuropsychological testing, Plasma measures of Aβ40, Aβ42, NFL and p-tau

Source: https://euclinicaltrials.eu/ctis-public/view/2024-513499-16-00